EU clinical trial 2022-502122-41-00: An Open-label, Randomized Phase 3 Study to Evaluate Efficacy and Safety of Pembrolizumab (MK-3475) in Combination with Belzutifan (MK-6482) and Lenvatinib (MK-7902), or MK-1308A in Combination with Lenvatinib, versus Pembrolizumab and Lenvatinib, as First-line Treatment in Participants with Advanced Clear Cell Renal Cell Carcinoma (ccRCC)
Protocol code: MK-6482-012
Sponsor: Merck Sharp & Dohme LLC (Pharmaceutical company). Phase: Therapeutic confirmatory (Phase III). Countries: Germany (ended), France (ongoing, recruitment ended), Denmark (ongoing, recruitment ended), Sweden (ongoing, recruitment ended), Finland (ongoing, recruitment ended), Romania (ongoing, recruitment ended), Italy (ongoing, recruitment ended), Spain (ongoing, recruitment ended), Ireland (ongoing, recruitment ended), Norway (ongoing, recruitment ended), Hungary (ongoing, recruitment ended), Czechia (ongoing, recruitment ended), Croatia (ongoing, recruitment ended), Poland (ongoing, recruitment ended).
Therapeutic area(s): Diseases [C] - Neoplasms [C04]
Gender: Female, Male. Age: 18-64 years, 65+ years. Enrolment: 491.
Start date (EU): 2021-05-11. Decision date: 2023-08-25. Results received: No. Last updated: 2026-06-03.
Decision dates by country: NO: 2023-09-13, FI: 2023-08-28, PL: 2023-10-17, RO: 2023-08-30, DK: 2023-08-28, ES: 2023-08-25, HU: 2023-08-28, HR: 2023-08-30, CZ: 2023-08-30, DE: 2023-09-11, IE: 2023-09-05, FR: 2023-09-06, IT: 2023-09-01, SE: 2023-08-28

Condition(s): Clear cell renal cancer
Product: KEYTRUDA 25 mg/mL concentrate for solution for infusion, Belzutifan, MK-1308A, Lenvatinib, Lenvatinib

Primary endpoint: Progression-Free Survival (PFS) According to Response Evaluation Criteria in Solid Tumors Version 1.1 (RECIST 1.1) as Assessed by Blinded Independent Central Review (BICR), Overall Survival (OS)
Endpoint(s): Objective Response Rate (ORR) Per RECIST 1.1 as Assessed by BICR, Duration of Response (DOR) Per RECIST 1.1 as Assessed by BICR, Number of Participants Who Experienced At least One Adverse Event (AE), Number of Participants Who Discontinue Study Treatment Due to an AE

Source: https://euclinicaltrials.eu/ctis-public/view/2022-502122-41-00